EU clinical trial 2023-503755-10-00: Phase 3, interventional, multicentre, open label, randomized study comparing rituximab plus zanubrutinib to rituximab monotherapy in previously untreated, symptomatic splenic marginal zone lymphoma (RITZ)
Protocol code: IELSG48
Sponsor: Association International Extranodal Lymphoma Study Group (Laboratory/Research/Testing facility). Phase: Therapeutic confirmatory (Phase III). Countries: Italy (ongoing, recruitment ended), France (ongoing, recruitment ended), Spain (ongoing, recruitment ended), Austria (ongoing, recruitment ended), Sweden (ongoing, recruitment ended), Denmark (ended), Norway (ongoing, recruitment ended).
Therapeutic area(s): Diseases [C] - Neoplasms [C04]
Gender: Female, Male. Age: 18-64 years, 65+ years. Enrolment: 90.
Start date (EU): 2024-05-17. Decision date: 2024-04-24. Results received: No. Last updated: 2026-07-09.
Decision dates by country: IT: 2024-04-24, ES: 2024-04-24, AT: 2024-04-29, DK: 2024-08-07, NO: 2024-08-09, SE: 2025-08-11, FR: 2024-04-24

Condition(s): Splenic marginal zone lymphoma
Product: Zanubrutinib, Truxima 500 mg concentrate for solution for infusion

Primary endpoint: Investigator-assessed PFS rate at 3 years according to the Lugano 2014 criteria
Endpoint(s): Investigator-assessed complete remission rates achieved at 12 and 24 months of treatment, assessed according to the Lugano 2014 criteria., Investigator-assessed best response achieved at any time during the treatment period (24 months) assessed according to the Lugano 2014 criteria, Investigator-assessed complete remission rates achieved at 12 and 24 months of treatment, assessed according to the Matutes criteria, Investigator-assessed best response achieved at any time during the treatment period (24 months) assessed according to the Matutes criteria, Investigator-assessed Time to next anti-lymphoma treatment (TTNT) according to the Lugano 2014 criteria, Investigator-assessed duration of response according to the Lugano 2014 criteria, Overall Survival according to the Lugano 2014 criteria, Analysis of type and severity of adverse events (AEs) according to the National Cancer Institute Common Terminology Criteria for Adverse Events (NCI-CTCAE) v5.0

Source: https://euclinicaltrials.eu/ctis-public/view/2023-503755-10-00